EU clinical trial 2024-513820-40-00: A Randomized & Observational phase II trial comparing the activity of TrabectedIn vs gemCitabine in patients with metastatic or locally advanced LEiomyosarcoma pretreated with conventional chemotherapy
Sponsor: Italian Sarcoma Group (Patient organisation/association). Phase: Therapeutic exploratory (Phase II). Countries: Italy (ongoing, recruiting).
Therapeutic area(s): Diseases [C] - Neoplasms [C04]; Analytical, Diagnostic and Therapeutic Techniques and Equipment [E] - Therapeutics [E02]
Gender: Female, Male. Age: 18-64 years, 65+ years. Enrolment: 100.
Status: Ongoing, recruiting. Start date (EU): 2021-10-29. Decision date: 2024-06-10. Results received: No. Last updated: 2026-05-13.

Condition(s): Metastatic or locally advanced leiomyosarcoma
Product: Gemcitabina Accord 100 mg/ml concentrato per soluzione per infusione., Trabectedina Teva 1 mg polvere per concentrato per soluzione per infusione, Gemcitabina Accord 100 mg/ml concentrato per soluzione per infusione., Gemcitabina Accord 100 mg/ml concentrato per soluzione per infusione., Trabectedina Teva 0,25 mg polvere per concentrato per soluzione per infusione, Yondelis 0.25 mg powder for concentrate for solution for infusion, Gemcitabina Accord 100 mg/ml concentrato per soluzione per infusione., Yondelis 1 mg powder for concentrate for solution for infusion

Primary endpoint: Compare the growth modulation index (GMI) in patients treated with Trabectedin or Gemcitabine for locally relapsed/metastatic leiomyosarcoma pretreated with anthracycline-based chemotherapy. GMI is the ratio of time to progression with the nth line (TTPn) of therapy to the TTPn−1 with the n-1th line. GMI >1.33 is considered as a sign of activity in phase II trials (Penel Ann Oncology). GMI will be calculated as the ratio between TTPTrabectedin/Gemcitabine and TTPfirst line.
Endpoint(s): To evaluate Overall Response Rate (ORR) determined by RECIST, version 1.1 in patients with advanced leiomyosarcoma treated with Trabectedin compared to patients treated with Gemcitabine., To evaluate overall survival (OS) in patients with advanced leiomyosarcoma treated with Trabectedin compared to patients treated with Gemcitabine, To evaluate Progression Free Survival (PFS) and Progression Free Survival Rate (PFSR) at 6 months in patients with advanced leiomyosarcoma treated with Trabectedin compared to patients treated with Gemcitabine, To evaluate duration of response (DOR) per RECIST, version 1.1 in patients with advanced leiomyosarcoma treated with Trabectedin compared to patients treated with Gemcitabine., To evaluate GMI2 calculated as the ratio of TTPthird line and TTPsecond line in the subset of patients who crossed over after progression to second line, To evaluate the safety and tolerability of Trabectedin compared to Gemcitabine, Exploratory objectives will be to identify gene mutations that may be associated to response/resistance to the treatment and to clinical outcomes parameters. Patients will be also exploratory evaluated according to the following subgroups: - age (<65 vs. ≥65) - sex (males vs. females) - site of disease (uterine LMS and non-uterine LMS) - ECOG performance status (0 vs. ≥1). -First line anthracycline based chemotherapy (single agent vs. combined chemotherapy)

Source: https://euclinicaltrials.eu/ctis-public/view/2024-513820-40-00